EU clinical trial 2024-511074-80-01: A multicenter, first-in-human, dose escalation and optimization phase I/IIa study to investigate safety, tolerability, pharmacokinetics, and efficacy of the NaPi2b antibody-drug conjugate TUB-040 in patients with platinum-resistant high-grade ovarian cancer (PROC) or relapsed/refractory adenocarcinoma non-small cell lung cancer (NSCLC) (NAPISTAR 1-01).
Protocol code: NAPISTAR 1-01
Sponsor: Tubulis GmbH (Pharmaceutical company). Phase: Phase I and Phase II (Integrated)- First administration to humans. Countries: Spain (ongoing, recruiting), Belgium (ongoing, recruiting), Germany (ongoing, recruiting), Romania (ongoing, recruiting).
Therapeutic area(s): Diseases [C] - Neoplasms [C04]; Diseases [C] - Respiratory Tract Diseases [C08]; Diseases [C] - Female Urogenital Diseases and Pregnancy Complications [C13]
Gender: Female, Male. Age: 18-64 years, 65+ years. Enrolment: 174.
Status: Ongoing, recruiting. Start date (EU): 2024-09-06. Decision date: 2024-08-12. Results received: No. Last updated: 2026-04-15.
Decision dates by country: ES: 2024-08-12, DE: 2024-08-16, RO: 2025-07-14, BE: 2024-08-22

Condition(s): Platinum-resistant high-grade ovarian cancer (PROC) or relapsed/refractory adenocarcinoma non-small cell lung cancer (NSCLC)
Product: TUB-040

Primary endpoint: Phase I: Incidence of dose-limiting toxicities (DLTs) at different dose levels, Phase I: Incidence and severity of treatment-emergent adverse events (TEAEs), Phase II: Incidence and severity of TEAEs, Phase II: Overall response rate (ORR) as assessed by BICR
Endpoint(s): Key Secondary: •Duration of response (DoR) as assessed by BICR, Phase IIa: Dose optimization: •Progression free survival (PFS), disease control rate (DCR) as assessed by BICR •Overall response rate (ORR), duration of response (DoR), progression free survival (PFS), disease control rate (DCR) as assessed by INV •Overall survival •Incidence of Grade ≥3 lab abnormalities •Incidence of serious adverse events (SAEs), Phase I: Dose Escalation: • Overall response rate (ORR), duration of response (DoR), progression free survival (PFS), and disease control rate (DCR) as assessed by INV • Incidence of Grade ≥3 lab abnormalities • Incidence of serious adverse events (SAEs), Phase I and IIa: •PK parameters of TUB-040, total mAb and free exatecan, including Cmax, Cmin, Tmax, and as far as collected data allow for a calculated estimation of t1/2, and area under the curve (AUC), Phase I and IIa: •Number and percentage of patients developing anti-TUB-040 antibodies, and semiquantitative titer assessments

Source: https://euclinicaltrials.eu/ctis-public/view/2024-511074-80-01